EU clinical trial 2023-508638-32-00: Intermittent ibrutinib in chronic lymphocytic leukemia
Sponsor: Karolinska University Hospital (Hospital/Clinic/Other health care facility). Phase: Human Pharmacology (Phase I)- Other. Countries: Sweden (ended), Norway (ended).
Therapeutic area(s): Diseases [C] - Neoplasms [C04]
Gender: Female, Male. Age: 18-64 years, 65+ years. Enrolment: 50.
Status: Ended. Start date (EU): 2018-04-06. End date (EU): 2026-04-20. Decision date: 2023-11-08. Results received: No. Last updated: 2023-11-10.
Decision dates by country: SE: 2023-11-08, NO: 2023-11-10

Condition(s): Chronic lymphocytic leukemia

Source: https://euclinicaltrials.eu/ctis-public/view/2023-508638-32-00